EU clinical trial 2024-510793-24-00: Feasibility of fluorescence imaging with bevacizumab-800CW during bronchoscopy in patients with a pulmonary lesion considered to be malignant - DFLECT I
Protocol code: 20210028
Sponsor: Universitair Medisch Centrum Groningen (Hospital/Clinic/Other health care facility). Phase: Therapeutic exploratory (Phase II). Countries: Netherlands (authorised, recruitment pending).
Therapeutic area(s): Diseases [C] - Neoplasms [C04]
Gender: Female, Male. Age: 18-64 years, 65+ years. Enrolment: 20.
Status: Authorised, recruitment pending. Decision date: 2026-07-06. Results received: No. Last updated: 2026-07-06.

Condition(s): suspected malignant pulmonary disease (lung lesions and/or lymph nodes suspicious for lung cancer)
Product: Avastin 25 mg/ml concentrate for solution for infusion.

Primary endpoint: Comparison of the in vivo fluorescent signal of malignant lesion (pulmonary nodule or lymph node metastasis) versus non-tumorous tissue: The fluorescent signal will be assessed qualitatively (categorical data) and quantitatively (pulmonary nodule: by multi-diameter single fiber reflectance spectroscopy/single-fiber fluorescence spectroscopy (MDSFR/SFF), lymph node metastases: by ultrasound guided needle biopsy single-fiber fluorescence (USNB/SFF)).
Endpoint(s): Correlation of the fluorescence signals detected in vivo and ex vivo, with histopathology/cytology result., Most optimal dose of bevacizumab-800CW for fluorescence molecular bronchoscopy by assessment of in vivo tumor-to-background ratios., Assessment of safety of bevacizumab-800CW injection and procedures in relation with fluorescent molecular imaging through summaries of adverse events, including data on the additional time (in minutes) needed for in vivo qualitative and quantitative assessment of the fluorescent signal. Adverse event data will be recorded and summarized according to NCI CTCAE v5.0.

Source: https://euclinicaltrials.eu/ctis-public/view/2024-510793-24-00